EU clinical trial 2023-509179-18-00: Mevrometostat Treatment Of Relapsed/Refractory SCLC, Castration Resistant Prostate Cancer, and Follicular Lymphoma
Protocol code: C2321001
Sponsor: Pfizer Inc. (Pharmaceutical company). Phase: Human Pharmacology (Phase I)- First administration to humans. Countries: Bulgaria (ended), Spain (ongoing, recruiting), Poland (ongoing, recruiting).
Therapeutic area(s): Diseases [C] - Neoplasms [C04]
Gender: Female, Male. Age: 18-64 years, 65+ years. Enrolment: 111.
Start date (EU): 2019-08-13. Decision date: 2024-08-28. Results received: No. Last updated: 2026-06-22.
Decision dates by country: BG: 2024-09-13, PL: 2024-10-09, ES: 2024-08-28

Condition(s): Small Cell Lung Cancer (SCLC), Diffuse Large B-Cell Lymphoma (DLBCL), Castration Resistant Prostate Cancer (CRPC), Follicular Lymphoma (FL)

Source: https://euclinicaltrials.eu/ctis-public/view/2023-509179-18-00